EU clinical trial 2023-508957-24-00: An open-label, non-randomized, biopsy-based mechanistic study on pharmacokinetics, pharmacodynamics, safety and tolerability of ianalumab in patients with Sjögren's syndrome
Protocol code: CVAY736A2103
Sponsor: Novartis Pharma AG (Pharmaceutical company). Phase: Therapeutic exploratory (Phase II). Countries: France (ended).
Therapeutic area(s): Diseases [C] - Immune System Diseases [C20]
Gender: Female, Male. Age: 18-64 years, 65+ years. Enrolment: 20.
Status: Ended. Start date (EU): 2022-07-27. End date (EU): 2026-01-05. Decision date: 2024-03-22. Results received: No. Last updated: 2025-04-29.

Condition(s): Sjögren's syndrome
Product: VAY736, ARTICAINE, COMBINATIONS, TENOFOVIR ALAFENAMIDE, PERFLUTREN, PHOSPHOLIPID MICROSPHERES, ENTECAVIR

Primary endpoint: Change from baseline in logarithm of salivary gland B/B+T cell ratio at Week 25 (EOT)
Endpoint(s): Occurrence of treatment emergent adverse events (both serious and non-serious) during the study and occurrence of treatment emergent abnormal vital signs, laboratory and ECG data over the study period., Change from baseline in SGUS parameters over the study period, Serum ianalumab concentrations during treatment and follow up. PK parameters AUCtau, AUClast, AUCinf, Cmax, Tmax, T1/2 after the last dose (if data permits) and any other parameters as required, Serum anti-ianalumab antibody (ADA assay) and incidence of ADA positive patients over the study period, Change from baseline in mean stimulated and unstimulated salivary flow rate changes over the study period

Source: https://euclinicaltrials.eu/ctis-public/view/2023-508957-24-00